EU clinical trial 2022-503135-33-00: Timely recovery after subclinical heart failure
Sponsor: University Hospital Maastricht (Hospital/Clinic/Other health care facility). Phase: Therapeutic use (Phase IV). Countries: Netherlands (ongoing, recruiting).
Therapeutic area(s): Diseases [C] - Cardiovascular Diseases [C14]
Gender: Female. Age: 18-64 years. Enrolment: 130.
Status: Ongoing, recruiting. Start date (EU): 2024-03-26. Decision date: 2023-07-28. Results received: No. Last updated: 2023-07-28.

Condition(s): Subclinical heart failure
Product: Valsartan 40 mg capsules, hard, Perindopril 2 mg, Tablets, Nitrospray 0,4 mg/devā aerosols lietošanai zem mēles, šķīdums, ALBUMIN

Primary endpoint: Left ventricular hypertrophy (Left ventricular mass index ≥95 g/m2), Concentric remodeling (relative wall thickness >0.43), Impaired systolic function (ejection fraction <55%), Significant valve dysfunction (American Society of Echocardiography guidelines), Signs of myocardial infarction (MI)
Endpoint(s): Blood pressure, Plasma volume, Quality of life, behavior and symptoms, Metabolic syndrome, Renin-angiotensin-aldosterone system, Novel biomarkers

Source: https://euclinicaltrials.eu/ctis-public/view/2022-503135-33-00